EU clinical trial 2022-501818-54-00: A study to test how BI 764532 is taken up by tumours in people with small-cell lung cancer or neuroendocrine cancer
Protocol code: 1438-0004
Sponsor: Boehringer Ingelheim International GmbH (Pharmaceutical company). Phase: Human Pharmacology (Phase I)- Other. Countries: Netherlands (ongoing, recruiting).
Therapeutic area(s): Diseases [C] - Neoplasms [C04]
Gender: Female, Male. Age: 18-64 years, 65+ years. Enrolment: 12.
Status: Ongoing, recruiting. Start date (EU): 2024-02-22. Decision date: 2023-08-17. Results received: No. Last updated: 2026-05-15.

Condition(s): Small cell lung carcinoma (SCLC), "Neuroendocrine carcinoma (NEC) or small cell carcinoma of any other origin", Large cells neuroendocrine lung carcinoma (LCNEC)

Source: https://euclinicaltrials.eu/ctis-public/view/2022-501818-54-00